EU clinical trial 2024-519263-18-00: Prevention of Group G/C Streptococcus Infections during Labour and postpartum - a randomized controlled multicenter trial (POGSI)
Sponsor: University Of Oulu (Educational Institution). Phase: Therapeutic use (Phase IV). Countries: Finland (ongoing, recruiting).
Therapeutic area(s): Diseases [C] - Female Urogenital Diseases and Pregnancy Complications [C13]
Gender: Female. Age: 18-64 years. Enrolment: 696.
Status: Ongoing, recruiting. Start date (EU): 2024-11-26. Decision date: 2024-11-26. Results received: No. Last updated: 2024-11-26.

Condition(s): Participants are pregnant women found to carry Group G or C Streptococcus as part of their vaginal-rectal flora in the late pregnancy vaginal-rectal culture routinely taken for GBS screening
Product: Clindamycin Fresenius Kabi 150 mg/ml injektioneste, liuos / infuusiokonsentraatti, liuosta varten, Benzylpenicillin Panpharma 3 g injektio-/infuusiokuiva-aine, liuosta varten

Primary endpoint: A postpartum infection of the mother requiring antibiotic treatment up to 3 months after delivery
Endpoint(s): Positive blood culture of the mother, mode of delivery, need for blood culture from the newborn, antibiotic treatment of the newborn, transfer to NICU, days in the hospital for the mother and the newborn (lenght of stay after birth/delivery)

Source: https://euclinicaltrials.eu/ctis-public/view/2024-519263-18-00